EU clinical trial 2024-513573-49-00: Tranexamic acid during excisional burn surgery
Sponsor: Maasstad Ziekenhuis Stichting (Hospital/Clinic/Other health care facility). Phase: Therapeutic use (Phase IV). Countries: Netherlands (ended).
Therapeutic area(s): Diseases [C] - Hemic and Lymphatic Diseases [C15]
Gender: Female, Male. Age: 18-64 years, 65+ years. Enrolment: 95.
Status: Ended. Start date (EU): 2021-11-03. End date (EU): 2025-11-26. Decision date: 2024-04-26. Results received: No. Last updated: 2024-04-26.

Condition(s): Burn injury
Product: Cyklokapron 100 mg/ml, oplossing voor injectie/infusie., Natriumchloride 0,9%, oplossing voor infusie

Primary endpoint: The main study endpoints are the volume of blood loss and the extend of fibrinolysis.
Endpoint(s): Blood transfusion requirements: - Number of blood product transfused Hospital Mortality Length of stay Operation success: - Success of skin graft (percentage successful take) Cardiopulmonary complication (i.e. arterial embolism) Neurologic complications (i.e. stroke, conclusion) Strength of the blood cloth and fibrin-structures

Source: https://euclinicaltrials.eu/ctis-public/view/2024-513573-49-00